EU clinical trial 2024-516497-29-00: Randomised, crossover bioequivalence clinical trial of vortioxetine 20 mg film-coated tablets, after a single oral dose administration to healthy volunteers under fasting conditions.
Protocol code: UECHUP-VOR/24-5
Sponsor: Laboratorios Alter S.A. (Pharmaceutical company). Phase: Human Pharmacology (Phase I)- Bioequivalence Study. Countries: Spain (ended).
Therapeutic area(s): Psychiatry and Psychology [F] - Mental Disorders [F03]
Gender: Female, Male. Age: 18-64 years. Enrolment: 24.
Status: Ended. Start date (EU): 2025-02-11. End date (EU): 2025-04-09. Decision date: 2024-12-20. Results received: No. Last updated: 2024-12-20.

Condition(s): Antidepressant

Source: https://euclinicaltrials.eu/ctis-public/view/2024-516497-29-00